EU clinical trial 2022-502869-17-01: FusionVAC22_01: DNAJB1-PRKACA fusion transcript-based peptide vaccine combined with immune checkpoint inhibition for fibrolamellar hepatocellular carcinoma and other tumor entities carrying the oncogenic driver fusion
Protocol code: FusionVAC22_01
Sponsor: Universitaetsklinikum Tuebingen (Hospital/Clinic/Other health care facility). Phase: Human Pharmacology (Phase I)- First administration to humans. Countries: Germany (ongoing, recruiting).
Therapeutic area(s): Diseases [C] - Digestive System Diseases [C06]
Gender: Female, Male. Age: 18-64 years, 65+ years. Enrolment: 20.
Status: Ongoing, recruiting. Start date (EU): 2023-09-26. Decision date: 2023-08-29. Results received: No. Last updated: 2025-10-14.

Condition(s): tumor entities carrying the oncogenic driver fusion DNAJB1-PRKACA, fibrolamellar hepatocellular carcinoma

Source: https://euclinicaltrials.eu/ctis-public/view/2022-502869-17-01